EU clinical trial 2023-503398-39-00: IMPROCAS - Improved Prediction of Ovarian Cancer Surgery
Sponsor: Aarhus University (Educational Institution). Phase: Therapeutic exploratory (Phase II). Countries: Denmark (ongoing, recruiting).
Therapeutic area(s): Analytical, Diagnostic and Therapeutic Techniques and Equipment [E] - Investigative Techniques [E05]; Diseases [C] - Neoplasms [C04]; Diseases [C] - Female Urogenital Diseases and Pregnancy Complications [C13]
Gender: Female. Age: 18-64 years, 65+ years. Enrolment: 40.
Status: Ongoing, recruiting. Start date (EU): 2024-03-01. Decision date: 2023-12-04. Results received: No. Last updated: 2025-05-30.

Condition(s): Ovarian cancer
Product: Hyperpolarized [1-13C]pyruvate, Dotarem, injektionsvæske, opløsning i enkeltdosisbeholder. i.v.

Primary endpoint: - to evaluate the diagnostic performance of DCE MRI, DKI and 31P MRS, - to create a diagnostic algorithm that can help the clinician to classify correct diagnosis and FIGO-staging of ovarian cancer., - to assess if the HP 13C MRI contributes to correct histopathological diagnosis., - to assess if the HP 13C MRI contributes to staging of ovarian cancer., - For the NMR-derived analyses from the blood samples: the ability to distinguish patients with cancer from those without cancer., For the NMR-derived analyses from the blood samples: the prediction of correct histopathological diagnosis
Endpoint(s): - To assess the repeatability and reproducibility of multiparametric pelvic MRI in patients suspected with ovarian cancer, For the NMR-derived analyses from the blood samples: - the prediction of surgical resectability

Source: https://euclinicaltrials.eu/ctis-public/view/2023-503398-39-00